EU clinical trial 2024-519337-35-00: Exploring Eptinezumab: Unveiling Peripheral and Central Mechanisms of Action and Searching for Biomarkers of Patient Response (EUPHORIA Study)
Protocol code: EUPHORIA
Sponsor: Ospedale San Raffaele S.r.l. (Hospital/Clinic/Other health care facility). Phase: Therapeutic use (Phase IV). Countries: Italy (ongoing, recruiting).
Therapeutic area(s): Diseases [C] - Nervous System Diseases [C10]
Gender: Female, Male. Age: 18-64 years, 65+ years. Enrolment: 60.
Status: Ongoing, recruiting. Start date (EU): 2026-01-08. Decision date: 2025-04-30. Results received: No. Last updated: 2026-02-10.

Condition(s): Migraine
Product: VYEPTI 100 mg concentrate for solution for infusion

Primary endpoint: Differences between patients with migraine and healthy controls at baseline in serum levels of calcitonin gene-related peptide, transcriptomic profiles on inflammatory and pain mediators, AUC and degree of habituation of the second component of the nociceptive blink reflex, resting state (RS) functional connectivity (FC) of brain networks involved in pain processing., 2a. Any of the following measures in patients showing significant changes from baseline to week 12 of eptinezumab 100mg: serum levels of CGRP, Transcriptomic profiles on inflammatory and pain mediators, AUC and degree of habituation of the second component of the nociceptive blink reflex (R2), RS FC of brain networks involved in pain processing, 2b. Correlation between changes in the identified candidate measure(s) of sensitization (serum CGRP levels, transcriptomic profiles, RS FC of pain processing brain networks, AUC, and degree of habituation of the R2 component of the nociceptive blink reflex) and changes in clinical efficacy measures following a 12-week treatment with eptinezumab at doses of 100mg.
Endpoint(s): 1a. Differences in changes of any of the candidate measures of sensitization (serum CGRP levels, transcriptomic profiles, RS FC of pain processing brain networks, AUC, and degree of habituation of the R2 component of the nociceptive blink reflex), from week 12 to week 24, between patients receiving eptinezumab 100mg and those receiving eptinezumab 300mg;, 1b. Correlation between changes in the identified candidate measure(s) of sensitization and changes in clinical efficacy measures following a 12-week treatment with eptinezumab at doses of 300mg., 2. Differences in changes of any of the candidate measures of sensitization, from baseline to week 12, between responders and non-responders to eptinezumab 100mg. We will also assess differences in changes of any of the candidate measures of sensitization, from week 12 to week 24, between responders and non-responders to eptinezumab 300mg., 3. Correlations between changes in measures of central sensitization and measures of peripheral sensitization from baseline to week 12.

Source: https://euclinicaltrials.eu/ctis-public/view/2024-519337-35-00